EU clinical trial 2023-505626-34-01: PROMISE: Potassium correction for RAAS Optimization in Chronic Kidney Disease
Sponsor: University Medical Center Groningen (Hospital/Clinic/Other health care facility). Phase: Therapeutic use (Phase IV). Countries: Netherlands (ongoing, recruiting).
Therapeutic area(s): Diseases [C] - Nutritional and Metabolic Diseases [C18]; Diseases [C] - Cardiovascular Diseases [C14]
Gender: Female, Male. Age: 18-64 years, 65+ years. Enrolment: 44.
Status: Ongoing, recruiting. Start date (EU): 2024-05-16. Decision date: 2024-01-26. Results received: No. Last updated: 2025-12-12.

Condition(s): Chronic kidney disease
Product: IRBESARTAN, PATIROMER CALCIUM, microcrystalline cellulose and xanthan gum

Primary endpoint: The main trial endpoint is 24-hour urinary albumin excretion, adjusted for creatinine (albumin-creatinine ratio, ACR), at the end of each study period.
Endpoint(s): The main secondary endpoint is systolic and diastolic blood pressure, assessed by a 24-hour ambulatory blood pressure measurement at the end of each study period. Further secondary endpoints are plasma potassium levels, kidney function, as reflected by the estimated glomerular filtration rate (eGFR) using the combined cystatin C-creatinine-based CKD-EPI formula, the achieved irbesartan dose and the number of (sever) adverse events at the end of each study period.

Source: https://euclinicaltrials.eu/ctis-public/view/2023-505626-34-01